EU clinical trial 2024-515741-42-00: HAELO: A Phase 3, Multinational, Randomized, Double-Blind, Placebo-Controlled Study to Evaluate the Efficacy and Safety of NTLA-2002 in Participants With Hereditary Angioedema (HAE)
Protocol code: ITL-2002-CL-301
Sponsor: Intellia Therapeutics Inc. (Pharmaceutical company). Phase: Therapeutic confirmatory (Phase III). Countries: Netherlands (ongoing, recruitment ended), France (ongoing, recruitment ended), Germany (ongoing, recruitment ended).
Therapeutic area(s): Diseases [C] - Congenital, Hereditary, and Neonatal Diseases and Abnormalities [C16]
Gender: Female, Male. Age: 0-17 years, 18-64 years, 65+ years. Enrolment: 29.
Status: Ongoing, recruitment ended. Start date (EU): 2025-03-28. Decision date: 2025-02-24. Results received: No. Last updated: 2026-03-27.
Decision dates by country: NL: 2025-02-24, DE: 2025-02-26, FR: 2025-02-24

Condition(s): hereditary angioedema due to C1 esterase inhibitor deficiency (Type 1 or 2)
Product: SODIUM CHLORIDE, NTLA-2002

Primary endpoint: Time-normalized number of Investigator-confirmed HAE attacks from Week 5 through Week 28
Endpoint(s): Time-normalized number of Investigator- confirmed HAE attacks requiring on-demand treatment from Week 5 through Week 28, Time-normalized number of moderate or severe Investigator-confirmed HAE attacks from Week 5 through Week 28, Investigator-confirmed HAE attack-free status from Week 5 through Week 28, Change from baseline to Week 28 in AE-QoL Questionnaire total score

Source: https://euclinicaltrials.eu/ctis-public/view/2024-515741-42-00